EU clinical trial 2024-512115-50-00: A Phase 2b Open-label Study of Selinexor (KPT-330) in Patients with Relapsed/Refractory Diffuse Large B-Cell Lymphoma (DLBCL)
Protocol code: KCP-330-009
Sponsor: Karyopharm Therapeutics Inc. (Pharmaceutical company). Phase: Therapeutic exploratory (Phase II). Countries: Italy (ongoing, recruitment ended), Poland (ongoing, recruitment ended), Greece (ongoing, recruitment ended).
Therapeutic area(s): Diseases [C] - Neoplasms [C04]
Gender: Female, Male. Age: 18-64 years. Enrolment: 30.
Status: Ongoing, recruitment ended. Start date (EU): 2016-06-22. Decision date: 2024-06-24. Results received: No. Last updated: 2026-04-22.
Decision dates by country: PL: 2024-06-24, GR: 2024-09-09, IT: 2024-06-25

Condition(s): Relapsed/Refractory DLBCL, Relapsed/Refractory DLBCL, Relapsed/Refractory DLBCL

Source: https://euclinicaltrials.eu/ctis-public/view/2024-512115-50-00